EU clinical trial 2025-523010-89-00: Phase Ib Dose-Ranging Study of the Safety, PK, PD & Efficacy of the Activin Signaling Inhibitor HS235 vs placebo added to background therapy in PAH (SEASIDE)
Protocol code: HS235-002
Sponsor: 35Pharma Inc. (Pharmaceutical company). Phase: Human Pharmacology (Phase I)- Other. Countries: Hungary (authorised, recruitment pending), Spain (authorised, recruitment pending), Poland (authorised, recruitment pending), Germany (authorised, recruitment pending), Czechia (authorised, recruitment pending).
Therapeutic area(s): Diseases [C] - Cardiovascular Diseases [C14]
Gender: Female, Male. Age: 18-64 years, 65+ years. Enrolment: 17.
Status: Authorised, recruitment pending. Decision date: 2025-12-23. Results received: No. Last updated: 2026-07-08.
Decision dates by country: CZ: 2026-04-07, PL: 2026-03-02, ES: 2026-01-07, HU: 2026-01-07, DE: 2026-03-20

Condition(s): Pulmonary arterial hypertension

Source: https://euclinicaltrials.eu/ctis-public/view/2025-523010-89-00